EU clinical trial 2025-523359-71-00: CoCo3 - Comprehensive Health Effects of Combined Contraceptives: a 12-month randomized, controlled, open-label trial of E4+DRSP, EE20μg+DRSP and DRSP-only
Protocol code: CoCo3
Sponsor: Pohjois-Pohjanmaan hyvinvointialue, University Of Oulu (Hospital/Clinic/Other health care facility, Educational Institution). Phase: Therapeutic use (Phase IV). Countries: Finland (authorised, recruitment pending).
Therapeutic area(s): Phenomena and Processes [G] - Reproductive and Urinary Physiological Phenomena [G08]
Gender: Female. Age: 18-64 years. Enrolment: 156.
Status: Authorised, recruitment pending. Decision date: 2026-04-17. Results received: No. Last updated: 2026-04-17.

Condition(s): Contraception
Product: Slinda 4 mg kalvopäällysteinen tabletti, Drovelis 3 mg/14.2 mg film-coated tablets, Daylette 0,02 mg / 3 mg tabletti, kalvopäällysteinen

Primary endpoint: 12-month use of study preparation, endpoint visit

Source: https://euclinicaltrials.eu/ctis-public/view/2025-523359-71-00